EU clinical trial 2023-509549-11-00: BEFAST STUDY: [68Ga]Ga-FAPI total body PET/CT for Better and Faster imaging in cancer [68Ga]Ga-FAPI PET/CT for response evaluation during immune checkpoint inhibitor therapy in malignant melanoma
Sponsor: Rigshospitalet (Hospital/Clinic/Other health care facility). Phase: Therapeutic exploratory (Phase II). Countries: Denmark (ongoing, recruiting).
Therapeutic area(s): Diseases [C] - Neoplasms [C04]; Analytical, Diagnostic and Therapeutic Techniques and Equipment [E] - Diagnosis [E01]
Gender: Female, Male. Age: 18-64 years, 65+ years. Enrolment: 20.
Status: Ongoing, recruiting. Start date (EU): 2025-08-03. Decision date: 2025-03-07. Results received: No. Last updated: 2026-05-13.

Condition(s): Malignant melanoma
Product: 68GA-FAPI-46, Fluor-18-FDG, 400 MBq-210 GBq, injektionsvreske Fludeoxyglucose (18F)

Primary endpoint: Evaluate [68Ga]Ga-FAPI-46-uptake in malignant lesions on [68Ga]Ga-FAPI-46 PET/CT., Evaluate changes in [68Ga]Ga-FAPI-46-uptake in malignant lesions on [68Ga]Ga-FAPI-46 PET/CT during ICT., Compare the changes in malignant lesions on [68Ga]Ga-FAPI-46 PET/CT with changes on standard [18F]FDG PET/CT and clinical response during ICT.
Endpoint(s): Changes in [68Ga]Ga-FAPI-46 uptake during ICT in healthy tissue as a predictor of potential side effects., Compare changes on [68Ga]Ga-FAPI-46 PET/CT in healthy tissue with changes on standard [18F]FDG PET/CT., Correlation between [68Ga]Ga-FAPI-46-uptake on [68Ga]Ga-FAPI-46 PET/CT and levels of FAP activity biomarkers in serum blood samples., Correlation between [68Ga]Ga-FAPI-46-uptake on [68Ga]Ga-FAPI-46 PET/CT and levels of other biomarkers (e.g. ECM remodeling biomarkers) in serum blood samples., Correlation between levels of biomarkers in serum blood samples and treatment outcome.

Source: https://euclinicaltrials.eu/ctis-public/view/2023-509549-11-00